EU clinical trial 2023-510047-37-00: A randomized, double-blind, placebo-controlled, Phase 2b trial with an open-label extension to determine the safety and efficacy of GH001 in patients with treatment-resistant depression.
Protocol code: GH001-TRD-201
Sponsor: GH Research Ireland Limited (Pharmaceutical company). Phase: Therapeutic exploratory (Phase II). Countries: Poland (ended), Czechia (ended), Germany (ended), Spain (ended), Ireland (ended).
Therapeutic area(s): Psychiatry and Psychology [F] - Mental Disorders [F03]
Gender: Female, Male. Age: 18-64 years. Enrolment: 81.
Status: Ended. Start date (EU): 2023-03-30. End date (EU): 2025-03-11. Decision date: 2024-10-25. Results received: Yes. Last updated: 2024-11-08.
Decision dates by country: CZ: 2024-10-30, DE: 2024-10-29, IE: 2024-10-30, ES: 2024-10-25, PL: 2024-11-08

Condition(s): Treatment-resistant depression (TRD)
Product: Mebufotenin, Mebufotenin, Inhalation vapour, liquid, Mebufotenin

Primary endpoint: Mean change in MADRS from Baseline to Day 7

Source: https://euclinicaltrials.eu/ctis-public/view/2023-510047-37-00